EU clinical trial 2024-516109-21-00: MITHRIDATE: A phase III, randomised, open-label, Multicenter International Trial comparing ruxolitinib with either HydRoxycarbamIDe or interferon Alpha as first line ThErapy for high risk polycythemia vera
Protocol code: RG_16-148
Sponsor: The University Of Birmingham (Educational Institution). Phase: Therapeutic confirmatory (Phase III). Countries: France (ongoing, recruiting).
Therapeutic area(s): Diseases [C] - Neoplasms [C04]; Diseases [C] - Hemic and Lymphatic Diseases [C15]
Gender: Female, Male. Age: 18-64 years, 65+ years. Enrolment: 293.
Status: Ongoing, recruiting. Start date (EU): 2024-12-09. Decision date: 2024-11-08. Results received: No. Last updated: 2025-04-29.

Condition(s): Polycythaemia Vera (PV)
Product: Hydroxycarbamide medac 500 mg capsule, hard, Pegasys 90 micrograms solution for injection in pre-filled syringe, Jakavi 5 mg tablets

Primary endpoint: Event Free Survival (EFS): defined as the time from randomisation to the date of the first event including: Major thrombosis, Major haemorrhage, Death, Transformation to MDS, AML or PPV-MF. Patients who do not experience an event during the trial will be censored at their date last seen.
Endpoint(s): 1. Major thrombosis (both combined and split into venous and arterial), 2. Major haemorrhage, 3. Transformation to PPV-MF, 4. Transformation to AML and/or MDS, 5. Complete haematological response (CHR) as defined by ELN response criteria at 1 year, 6. Symptom burden/(QALY)quality of life years gained, 7. Health economics including cost utility and cost effectiveness analyses, 8. Peripheral blood JAK2 V617F allele burden according to ELN response criteria, 9. Rates of discontinuation, 10. Adverse events, 11. Spleen response in patients with splenomegaly at Baseline, 12. Time free from venesection, 13. Rate of second malignancies, 14. Change in Qrisk score, Exploratory 1: Progression of marrow fibrosis, Exploratory 2: Impact of the treatment on molecular signatures of disease, Exploratory 3. Clonal involvement within the stem/progenitor cell compartment, Exploratory 4. Clonal evolution (acquisition of additional mutations), Exploratory 5. Reduction of peripheral blood allele burden of other disease-associated mutations, Exploratory 6. Assessment of the prevalence of clonality markers for haematological disease and any change over time, Exploratory 7. Correlation of thrombosis biomarkers with clinical thrombosis events, Exploratory Metabolic: 1. Cardiac event (angina, acute coronary syndrome, acute MI; arrhythmia), Exploratory Metabolic 2. Pulmonary hypertension, Exploratory Metabolic 3. Coronary intervention: e.g. angiogram, angioplasty, CABG, Exploratory Metabolic 4. Deterioration in cardiac function e.g. LVEF% on ECHO/ MUGA and/or NYHA classification, Exploratory Metabolic 5. Cerebrovascular event (TIA, haemorrhagic CVA, non-haemorrhagic CVA), Exploratory Metabolic 6. Arterial vascular event (peripheral vascular disease: claudication, carotid stenosis), Exploratory Metabolic 7. Venous thrombosis including DVT, PE, Cerebral, splanchnic, other, Exploratory Metabolic 8. Pregnancy loss

Source: https://euclinicaltrials.eu/ctis-public/view/2024-516109-21-00